EU clinical trial 2024-519031-42-00: A randomized phase III trial of short-course versus long-course pre-operative chemotherapy with mFOLFIRINOX or PAXG regimen for stage I-III pancreatic ductal adenocarcinoma (PDAC)
Protocol code: PACT-21/CASSANDRA
Sponsor: Associazione Italiana Per Lo Studio Del Pancreas (Patient organisation/association). Phase: Therapeutic confirmatory (Phase III). Countries: Italy (authorised, recruitment pending).
Therapeutic area(s): Diseases [C] - Pathological Conditions, Signs and Symptoms [C23]
Gender: Female, Male. Age: 18-64 years. Enrolment: 261.
Status: Authorised, recruitment pending. Decision date: 2024-11-18. Results received: No. Last updated: 2026-06-16.

Condition(s): pancreatic ductal adenocarcinoma
Product: Abraxane 5 mg/ml powder for dispersion for infusion., CAPECITABINE VIATRIS 150 mg, comprimé pelliculé, CAPECITABINE VIATRIS 500 mg, comprimé pelliculé, IRINOTECAN VIATRIS 20 mg/ml, solution à diluer pour perfusion, Fluorouracil/Anabiosis 50 mg/ml διάλυμα για ένεση ή έγχυση, Oxaliplatino Aurovit 5 mg/ml concentrado para solución para perfusión EFG, Leucovorin 10 mg/ml Lösung zur Injektion/ Infusion, Gemcitabine Accord 100 mg/ml koncentratas infuziniam tirpalui, Cisplatino Sandoz 0,5 mg/ml – Concentrato per soluzione per infusione

Primary endpoint: EFS, defined as the time from randomization to: RECIST 1.1 progression [At least a 20% increase in the sum of diameters of target lesions, taking as reference the smallest sum on study
Endpoint(s): OS, RECIST 1.1 response rate, CA19.9 response rate, complete pathologic response, resectability rate, surgical mortality and morbidity rate, intra- and post-operative metastasis rate, N0 and R0 resections rate, patients reported outcomes, treatment toxicity

Source: https://euclinicaltrials.eu/ctis-public/view/2024-519031-42-00